EU clinical trial 2024-519485-50-00: A PHASE I, COMBINED STUDY OF THE SAFETY, TOLERABILITY, AND PHARMACOKINETICS OF SZV-1287 IN HEALTHY MALE VOLUNTEERS AFTER SINGLE ASCENDING AND MULTIPLE ASCENDING ORAL DOSES FOR 7 DAYS
Protocol code: SZV-1287-0020
Sponsor: University Of Pecs (Educational Institution). Phase: Human Pharmacology (Phase I)- First administration to humans. Countries: Hungary (authorised, recruiting).
Therapeutic area(s): Diseases [C] - Nervous System Diseases [C10]
Gender: Male. Age: 18-64 years. Enrolment: 68.
Status: Authorised, recruiting. Start date (EU): 2024-11-25. Decision date: 2024-11-25. Results received: No. Last updated: 2026-07-08.

Condition(s): neuropathic pain

Source: https://euclinicaltrials.eu/ctis-public/view/2024-519485-50-00